EU clinical trial 2024-517085-41-00: A Study of Safety, Tolerability, and Clinical Activity of Durvalumab and Tremelimumab Administered as Monotherapy, or Durvalumab in Combination with Tremelimumab or Bevacizumab in Subjects with Advanced Hepatocellular Carcinoma
Protocol code: D4190C00022
Sponsor: AstraZeneca AB (Pharmaceutical company). Phase: Therapeutic exploratory (Phase II). Countries: Italy (ongoing, recruitment ended).
Therapeutic area(s): Diseases [C] - Neoplasms [C04]
Gender: Female, Male. Age: 18-64 years, 65+ years. Enrolment: 2.
Status: Ongoing, recruitment ended. Start date (EU): 2016-05-16. Decision date: 2024-10-16. Results received: No. Last updated: 2025-06-12.

Condition(s): Hepatocellular Carcinoma
Product: IMFINZI 50 mg/mL concentrate for solution for infusion., BEVACIZUMAB, IMJUDO 20 mg/ml concentrate for solution for infusion.

Primary endpoint: Number (percentage) of subjects reporting adverse events and number (percentage) of subjects reporting serious adverse events., Number (percentage) of subjects discontinuing investigational product(s) due to toxicity., Changes from baseline in laboratory parameters (including liver and viral laboratory tests), electrocardiograms and vital signs.
Endpoint(s): Objective response rate (ORR), disease control rate (DCR), time to response (TTR), duration of response (DoR), time to progression (TTP), progression-free survival (PFS) based on investigator assessments and Blinded Independent Central Review (BICR) according to Response Evaluation Criteria in Solid Tumors (RECIST) v1.1, and overall survival (OS)., AEs, SAEs, discontinuation of investigational product(s) due to toxicity, and changes from baseline in laboratory parameters (including liver and viral laboratory tests), ECG, and vital signs in 3 distinct HCC populations: uninfected, HBV+, and HCV+., PD-L1 expression within the tumor microenvironment.

Source: https://euclinicaltrials.eu/ctis-public/view/2024-517085-41-00